EU clinical trial 2026-525783-18-00: Efficacy of sufentanil in urgent laparoscopic cholecystectomy: An alternative to the usual opioids for postoperative pain?
Protocol code: SUFEN_VIGO_2026
Sponsor: Fundacion Biomedica Galicia Sur (Patient organisation/association). Phase: Therapeutic confirmatory (Phase III). Countries: Spain (authorised, recruitment pending).
Therapeutic area(s): Diseases [C] - Digestive System Diseases [C06]
Gender: Female, Male. Age: 18-64 years, 65+ years. Enrolment: 66.
Status: Authorised, recruitment pending. Decision date: 2026-06-08. Results received: No. Last updated: 2026-06-08.

Condition(s): Laparoscopic cholecystectomy
Product: SUFENTANIL, FENTANYL

Primary endpoint: Visual Analogue Scale (VAS)
Endpoint(s): Age, Sex, Weight, Height, ASA, VAS at the first postoperative hour, VAS at the second postoperative hour, VAS at the 12th postoperative hour, Postoperative nausea or vomiting, Pruritus, Respiratory depression, Micrograms of opioids administered during surgery, Opioid use in the first 24 hours

Source: https://euclinicaltrials.eu/ctis-public/view/2026-525783-18-00